EU clinical trial 2023-503451-94-00: TAYLOR : A multicentric phase II trial evaluating volrustomig (MEDI5752) in patients with mature tertiary lymphoid structures solid tumors.
Protocol code: 2023-01
Sponsor: Institut Bergonie (Hospital/Clinic/Other health care facility). Phase: Therapeutic exploratory (Phase II). Countries: France (expired).
Therapeutic area(s): Diseases [C] - Neoplasms [C04]
Gender: Female, Male. Age: 18-64 years, 65+ years. Enrolment: 102.
Status: Expired. Decision date: 2023-10-16. Results received: No. Last updated: 2025-04-30.

Condition(s): Adult participants with metastatic (advanced) solid tumors
Product: volrustomig

Primary endpoint: Antitumour activity will be assessed in terms of objective response rate (ORR) RECIST v1.1, independently for each cohort :
Endpoint(s): 24-weeks clinical benefit rate (CBR), Best overall response throughout the treatment period (BoR), Duration of response from documentation of tumour response to disease progression (DoR), 1-year and 2-year progression-free survival (PFS), Growth modulation index (GMI), 1-year and 2-year overall survival (OS), Safety profile of volrustomig, Correlate tumor microenvironment features (including but not limited to density of immune cells, expression of exhaustion markers), plasma metabolomics, plasma proteomics with patient outcome (objective response rate, PFS and OS).

Source: https://euclinicaltrials.eu/ctis-public/view/2023-503451-94-00